EU clinical trial 2025-521095-66-00: A study in healthy men to find out how different doses of BI 3009947 are tolerated and how different formulations or food influence how BI 3009947 is taken up into the blood
Protocol code: 1533-0001
Sponsor: Boehringer Ingelheim International GmbH (Pharmaceutical company). Phase: Human Pharmacology (Phase I)- First administration to humans. Countries: Germany (ended).
Therapeutic area(s): Not possible to specify
Gender: Male. Age: 18-64 years. Enrolment: 68.
Status: Ended. Start date (EU): 2025-11-19. End date (EU): 2026-03-25. Decision date: 2025-09-19. Results received: No. Last updated: 2026-01-20.

Condition(s): Healthy volunteer trial

Source: https://euclinicaltrials.eu/ctis-public/view/2025-521095-66-00